EU clinical trial 2023-509247-27-00: Double blind, multicenter, randomized, controlled trial of dexmedetomidine vs placebo in premature neonates receiving invasive ventilation
Protocol code: DIVINEO
Sponsor: Centre Hospitalier Intercommunal Creteil (Hospital/Clinic/Other health care facility). Phase: Therapeutic confirmatory (Phase III). Countries: France (authorised, recruitment pending).
Therapeutic area(s): Analytical, Diagnostic and Therapeutic Techniques and Equipment [E] - Anesthesia and Analgesia [E03]; Diseases [C] - Congenital, Hereditary, and Neonatal Diseases and Abnormalities [C16]
Gender: Female, Male. Age: 0-17 years. Enrolment: 246.
Status: Authorised, recruitment pending. Decision date: 2026-02-18. Results received: No. Last updated: 2026-02-18.

Condition(s): Neonatal respiratory distress. Pain and discomfort
Product: Dexmedetomidine Viatris 100 mikrog/ml infuusiokonsentraatti, liuosta varten, GLUCOSE 5 % VANTIVE, solution pour perfusion

Primary endpoint: Cumulative dose of opioids (morphine, sufentanil, fentanyl) converted to equivalent morphine dose in µg/kg using fixed equipotency ratios based on national prescriptions habits, administered during the studied period defined as the time between the start of the investigational drug and the cessation of any opioid or of the investigational drug for at least 24 h, whichever comes last.
Endpoint(s): Pain and comfort outcomes: COMFORTneo pain and comfort scale, number of days with opioids and/or benzodiazepines, cumulative dose of midazolam (µg/kg), frequency of muscle blocker use;, Opioids’ adverse effects: age at full enteral feeding, urinary retention, Finnegan neonatal withdrawal scale, duration of invasive ventilation, extubation failure at 3 and 7 days after extubation, unplanned extubation, Dexmedetomidine’s tolerance: bradycardia (heart rate < 100/min for 5 consecutive minutes with SpO2> lower threshold for postmenstrual age), hypotension (mean arterial blood pressure in mmHg < postmenstrual age in weeks), anti-hypotensive treatments use, Safety outcomes at discharge: in-hospital mortality, total duration of invasive and non-invasive ventilation, total duration of NICU and hospital stay, high-grade intraventricular hemorrhage, periventricular leukomalacia, secondary sepsis, treated patent ductus arteriosus, bronchopulmonary dysplasia at 36 weeks postmenstrual age, necrotizing enterocolitis, isolated intestinal perforation, treated retinopathy of prematurity., Long-term neurodevelopment using tests validated in French: Parent Report of Children's Abilities-Revised (PARCA-R) at age 2 and BMT-i (Batterie Modulable de Tests informatisée, or "computerized Adaptable Test Battery") at age 6

Source: https://euclinicaltrials.eu/ctis-public/view/2023-509247-27-00